EU clinical trial 2024-514018-12-00: Phase-I/II trial for relapsed or refractory AML patients combining cytarabine and mitoxantrone with venetoclax (TUD-RELAX1-070)
Protocol code: TUD-RELAX1-070
Sponsor: Technische Universitaet Dresden (Educational Institution). Phase: Phase I and Phase II (Integrated)- Other. Countries: Germany (ended).
Therapeutic area(s): Diseases [C] - Neoplasms [C04]
Gender: Female, Male. Age: 18-64 years, 65+ years. Enrolment: 55.
Status: Ended. Start date (EU): 2020-04-06. End date (EU): 2025-09-24. Decision date: 2024-10-18. Results received: No. Last updated: 2024-10-18.

Condition(s): female and male adult patients with acute myeloid leukemia (AML) at first or second relapse after intensive chemotherapy including allogeneic stem cell transplantation or primary refractory to standard induction chemotherapy who are eligible for intensive salvage treatment
Product: Venetoclax, MITOXANTRONE, CYTARABINE, Venetoclax, Venetoclax

Primary endpoint: Phase I (Escalation part): Maximum tolerated dose of cytarabine in combination with venetoclax plus mitoxantrone in the framework of a 3+3 design, Phase II (Expansion part): CR/CRi rate

Source: https://euclinicaltrials.eu/ctis-public/view/2024-514018-12-00